EU clinical trial 2023-503337-21-00: BESTOW-EXTENSION: A Phase 2, Multicenter, Open-Label Extension Study to Evaluate the Long-Term Safety and Efficacy of Tegoprubart in Kidney Transplant Recipients
Protocol code: AT-1501-K209
Sponsor: Eledon Pharmaceuticals Inc. (Pharmaceutical company). Phase: Therapeutic exploratory (Phase II). Countries: Spain (ongoing, recruitment ended), Germany (ongoing, recruitment ended), France (ongoing, recruitment ended).
Therapeutic area(s): Phenomena and Processes [G] - Immune system processes [G12]
Gender: Female, Male. Age: 18-64 years. Enrolment: 30.
Status: Ongoing, recruitment ended. Start date (EU): 2025-02-28. Decision date: 2025-01-08. Results received: No. Last updated: 2025-08-12.
Decision dates by country: FR: 2025-01-10, DE: 2025-01-09, ES: 2025-01-08

Condition(s): Prophylaxis of Renal Allograft Rejection
Product: Prograf 5 mg hard capsules, Prograf 5 mg/ml concentrate for solution for infusion, AT-1501 190 mg Vial, Prograf 0.5 mg hard capsules, Prograf 1 mg hard capsules

Primary endpoint: Safety Endpoints: Incidence of treatment-emergent serious adverse events (TESAEs), treatment-emergent adverse events (TEAEs), and treatment-emergent AEs of special interest (AESIs)., Changes in vital signs and clinical laboratory measures., Kidney transplant medication side effects using the Modified Transplant Symptom Occurrence and Symptom Distress Scale (MTSOSD) at baseline and 12, 24, 36, and 48 months.
Endpoint(s): Efficacy endpoints: The proportion of participant and graft survival events at 12, 24, 36, and 48 months. Participant and graft survival events are defined as the earliest of either A) Death, B) Re-transplantation or C) Requirement for regular dialysis, The proportion of graft functional impairment at 12, 24, 36, and 48 months. A subject is considered to have graft functional impairment if they have an eGFR < 60 mL/min/1.73 m2, The mean eGFR at 12, 24, 36, and 48 months, Proportion of participants with BPAR at 12, 24, 36, and 48 months, Proportion of composite endpoint (graft failure, BPAR, or death) at 12, 24, 36, and 48 months

Source: https://euclinicaltrials.eu/ctis-public/view/2023-503337-21-00